EU clinical trial 2022-501138-49-00: ME-401 combined with rituximab-bendamustine for high-risk and rituximab with a 1:1 randomization to ME-401 for low-risk follicular lymphoma as primary treatment: a phase II study – NLG-FL5 (Follicular lymphoma and ME-401: FLAME)
Protocol code: NLG-FL5 FLAME
Sponsor: Karolinska University Hospital (Hospital/Clinic/Other health care facility). Phase: Therapeutic exploratory (Phase II). Countries: Sweden (ended).
Therapeutic area(s): Diseases [C] - Hemic and Lymphatic Diseases [C15]
Gender: Female, Male. Age: 18-64 years, 65+ years. Enrolment: 60.
Status: Ended. End date (EU): 2022-12-01. Decision date: 2022-10-14. Results received: No. Last updated: 2022-10-14.

Condition(s): Follicular Lymphoma

Source: https://euclinicaltrials.eu/ctis-public/view/2022-501138-49-00